EU clinical trial 2024-510682-42-01: Optimal drug therapy for the suppression of ventricular arrhythmias in Andersen-Tawil syndrome and multifocal ectopic Purkinje-related premature contractions: a series of N-of-1 trials
Sponsor: Amsterdam UMC (Hospital/Clinic/Other health care facility). Phase: Therapeutic use (Phase IV). Countries: Netherlands (authorised, recruiting).
Therapeutic area(s): Diseases [C] - Cardiovascular Diseases [C14]
Gender: Female, Male. Age: 18-64 years, 65+ years. Enrolment: 10.
Status: Authorised, recruiting. Start date (EU): 2025-08-13. Decision date: 2024-06-10. Results received: No. Last updated: 2024-07-12.

Condition(s): Andersen-Tawil syndrome, Multifocal Ectopic Purkinje-related Premature Contractions
Product: BISOPROLOL, METOPROLOL, NEBIVOLOL, VERAPAMIL, QUINIDINE, PROPRANOLOL, FLECAINIDE, ATENOLOL

Primary endpoint: The ventricular ectopy burden per 24-hour period.

Source: https://euclinicaltrials.eu/ctis-public/view/2024-510682-42-01